EU clinical trial 2024-514441-11-00: To evaluate the efficacy and safety of naxitamab in patients with refractory Ewing's sarcoma.
Protocol code: BUTTERFLY
Sponsor: Instytut Matki I Dziecka (Hospital/Clinic/Other health care facility). Phase: Therapeutic exploratory (Phase II). Countries: Poland (ongoing, recruiting).
Therapeutic area(s): Diseases [C] - Neoplasms [C04]
Gender: Female, Male. Age: 0-17 years, 18-64 years. Enrolment: 24.
Status: Ongoing, recruiting. Start date (EU): 2023-09-28. Decision date: 2024-08-06. Results received: No. Last updated: 2024-08-06.

Condition(s): Ewing's sarcoma
Product: Humanized IgG1 monoclonal antibody against GD2

Primary endpoint: Safety and tolerability will be assessed based on an analysis of adverse events on all enrolled subjects. These events will be divided according to severity, seriousness, affected organ or system and analyzed for:, number of serious adverse events (SAE), the number of adverse events (AE), including events of particular importance to the incidence and severity of adverse events occurring during treatment (TEAE) (encoded according to the preferred term and class of organ systems using the Medical Dictionary for Regulatory Activities (MedDRA); these events will be estimated according to the National Cancer Institute Common Terminology Criteria for Adverse Events version 5.0 (NCI CTCAE v5.0), the result of a medical examination with the analysis of recorded vital signs, assessment of laboratory abnormalities according to NCI CTCAE v5.0, This primary end point has been redacted following transparency rules and protection of confidential information.
Endpoint(s): To assess the efficacy of the use of naxitamab in combination with standard IT chemotherapy versus chemotherapy alone:, EFS (Event-Free Survival) - from randomization to the date of disease progression, recurrence, second malignancy, death or to date of last follow-up for patients without events,, PFS (Progression-Free Survival) - from randomization to progression of the disease,, ORR (Overall Response Rate) - defined as the proportion of patients with a best overall response of complete response (CR) or partial response (PR) according WHO criteria,, OS (Overall Survival) - from randomization to subject's death.

Source: https://euclinicaltrials.eu/ctis-public/view/2024-514441-11-00